EU clinical trial 2023-506520-90-00: A research study looking at how different doses of study medicine (Inno8) works in the body of healthy men.
Protocol code: NN7442-7582
Sponsor: Novo Nordisk A/S (Pharmaceutical company). Phase: Human Pharmacology (Phase I)- First administration to humans. Countries: Germany (ended).
Therapeutic area(s): Diseases [C] - Congenital, Hereditary, and Neonatal Diseases and Abnormalities [C16]
Gender: Male. Age: 18-64 years. Enrolment: 108.
Status: Ended. Start date (EU): 2024-09-16. End date (EU): 2026-03-26. Decision date: 2024-09-16. Results received: No. Last updated: 2025-12-11.

Condition(s): Prophylaxis and on-demand treatment respectively in patients with haemophilia A with or without FVIII inhibitors.

Source: https://euclinicaltrials.eu/ctis-public/view/2023-506520-90-00